EU clinical trial 2023-506702-39-00: Phase II Study of Trastuzumab-Deruxtecan (T-DXd; DS-8201a) in HER2-Low Breast Cancer Patients Presenting with Newly Diagnosed or Progressing Brain Metastases. (The TUXEDO-4 Study)
Protocol code: MEDOPP596
Sponsor: Medica Scientia Innovation Research S.L. (Pharmaceutical company). Phase: Therapeutic exploratory (Phase II). Countries: Austria (ongoing, recruitment ended), Spain (ongoing, recruitment ended).
Therapeutic area(s): Diseases [C] - Neoplasms [C04]
Gender: Female, Male. Age: 18-64 years, 65+ years. Enrolment: 27.
Status: Ongoing, recruitment ended. Start date (EU): 2024-06-05. Decision date: 2024-05-23. Results received: No. Last updated: 2026-07-17.
Decision dates by country: AT: 2024-05-29, ES: 2024-05-23

Condition(s): HER2-low breast cancer presenting with newly diagnosed or progressing brain metastases with or without type II leptomeningeal disease.
Product: DS-8201a

Primary endpoint: ORR at any timepoint determined by best CNS response per RANO-BM criteria.
Endpoint(s): ORR for EC and overall lesions, defined as the rate of patients with CR or PR, determined locally by the investigator per RECIST criteria v.1.1., Bi-CBR, defined as CR+PR+SD ≥ 24 weeks, determined locally by the investigator per RANO-BM criteria for IC lesions and RECIST criteria v.1.1 for both EC and overall lesions., Bi-DCR, defined as CR+PR+SD, determined locally by the investigator per RANO-BM criteria for IC lesions and RECIST criteria v.1.1 for both EC and overall lesions., TTR, defined as the period from the treatment initiation to time of the first objective tumor response (tumor shrinkage of ≥ 30%) observed for patients who achieved a CR or PR, as per RANO-BM for intracranial lesions and RECIST v.1.1 for extracranial and overall lesions., DoR, defined as the period from the first occurrence of a documented objective response to disease progression or death from any cause, observed for patients who achieved a CR or PR, as per RANO-BM for intracranial lesions and RECIST v.1.1 for extracranial and overall lesions. Best percentage of change in tumor burden as per RANO-BM for intracranial lesions and RECIST v.1.1 for extracranial and overall measurable lesions., PFS, defined as the period from treatment initiation to the first occurrence of disease progression or death from any cause, whichever occurs first. Progression will be determined locally per RANO-BM criteria for IC lesions and RECIST criteria v.1.1 for both EC and overall lesions., OS, defined as the period from treatment initiation to death from any cause, determined locally by the investigator., Safety and tolerability as per NCI-CTCAE v.5.0., Assessment of QoL with EORTC QLQ-c30, the brain specific tool (BN20), and the breast specific tool BR45., Neurologic function as per NANO scale., Exploratory endpoints still to be fully defined, but could include the evaluation of biomarkers associated with brain damage, the response to T-DXd or assessment of HER2 gene copy number changes throughout the treatment.

Source: https://euclinicaltrials.eu/ctis-public/view/2023-506702-39-00